EU clinical trial 2024-515731-29-00: SOLARIS – A phase-II open-label study of pembrolizumab and lenvatinib in patients with advanced stage hepatocellular carcinoma who are refractory to atezolizumab and bevacizumab/ IO-based therapy
Protocol code: SOLARIS
Sponsor: Frankfurter Institut Fuer Klinische Krebsforschung IKF GmbH (Pharmaceutical company). Phase: Therapeutic exploratory (Phase II). Countries: Germany (ended).
Therapeutic area(s): Diseases [C] - Neoplasms [C04]
Gender: Female, Male. Age: 18-64 years, 65+ years. Enrolment: 32.
Status: Ended. Start date (EU): 2022-03-30. End date (EU): 2025-06-30. Decision date: 2024-10-25. Results received: Yes. Last updated: 2025-08-01.

Condition(s): advanced stage hepatocellular carcinoma
Product: LENVIMA 4 mg hard capsules, KEYTRUDA 25 mg/mL concentrate for solution for infusion

Primary endpoint: Objective response rate (ORR) – percentage of patients with complete response (CR) or partial response (PR) according to RECIST 1.1.
Endpoint(s): Progression free survival (PFS), Overall survival (OS), Safety and Toxcitiy

Source: https://euclinicaltrials.eu/ctis-public/view/2024-515731-29-00